EU clinical trial 2025-522888-15-00: Phase 1b Study of Tarlatamab + ZL-1310 +/- Anti-PD-L1 in Small Cell Lung Cancer
Protocol code: 20250114
Sponsor: Amgen Inc. (Pharmaceutical company). Phase: Human Pharmacology (Phase I)- Other. Countries: Spain (ongoing, recruiting), Germany (ongoing, recruiting), Poland (ongoing, recruiting), Belgium (ongoing, recruiting), France (ongoing, recruiting).
Therapeutic area(s): Diseases [C] - Neoplasms [C04]
Gender: Female, Male. Age: 18-64 years, 65+ years. Enrolment: 53.
Status: Ongoing, recruiting. Start date (EU): 2026-05-27. Decision date: 2026-05-05. Results received: No. Last updated: 2026-05-11.
Decision dates by country: BE: 2026-05-11, FR: 2026-05-05, DE: 2026-05-08, ES: 2026-05-10, PL: 2026-05-08

Condition(s): Small Cell Lung Cancer

Source: https://euclinicaltrials.eu/ctis-public/view/2025-522888-15-00